EU clinical trial 2023-504168-40-00: A Phase 3 Randomized Double-blind Controlled Study to Evaluate the Immunogenicity, Safety, and Reactogenicity of ExPEC9V and High-dose Quadrivalent Influenza Vaccine, With and Without Co-administration, in Adults Aged 65 Years or Older
Sponsor: Janssen Vaccines & Prevention B.V. (Pharmaceutical company). Phase: Therapeutic confirmatory (Phase III). Countries: Belgium (ended), Poland (ended).
Therapeutic area(s): Diseases [C] - Bacterial Infections and Mycoses [C01]
Gender: Female, Male. Age: 65+ years. Enrolment: 400.
Status: Ended. Start date (EU): 2023-11-06. End date (EU): 2024-07-26. End date: 2024-07-27. Decision date: 2023-09-18. Results received: Yes. Last updated: 2024-06-11.
Decision dates by country: BE: 2023-09-18, PL: 2023-09-25

Condition(s): Prevention of invasive extraintestinal pathogenic Escherichia coli (ExPEC) disease
Product: Isotone Natriumchloridlösung 0,9 % Braun Injektionslösung, EFLUELDA, suspension injectable en seringue préremplie Vaccin grippal quadrivalent (virion fragmenté, inactivé), 60 microgrammes HA /souche, JNJ-78901563

Primary endpoint: Antibody hemagglutination inhibition (HI) titers as measured by HI assay against each of the 4 influenza vaccine strains, 29 days after the administration of a HD quadrivalent seasonal influenza vaccine. Antibody titers to vaccine O-serotype antigens, as determined by multiplex ECL-based immunoassay 29 days after administration of ExPEC9V.

Source: https://euclinicaltrials.eu/ctis-public/view/2023-504168-40-00